EU clinical trial 2024-510653-10-00: GERICO14 : Randomized phase III study of oral cyclophosphamide vs doxorubicin in 65 years or older patients with advanced or metastatic soft tissue sarcoma: a UNICANCER/GERICO multicenter program
Protocol code: UC-0103/1802
Sponsor: Unicancer (Hospital/Clinic/Other health care facility). Phase: Therapeutic confirmatory (Phase III). Countries: France (ongoing, recruiting).
Therapeutic area(s): Diseases [C] - Neoplasms [C04]
Gender: Female, Male. Age: 65+ years. Enrolment: 214.
Status: Ongoing, recruiting. Start date (EU): 2021-06-04. Decision date: 2024-04-26. Results received: No. Last updated: 2024-04-26.

Condition(s): Advanced or metastatic soft tissue sarcoma (STS) in patients ≥65 years old
Product: FILGRASTIM, CYCLOPHOSPHAMIDE, DOXORUBICIN, DEXRAZOXANE HYDROCHLORIDE

Primary endpoint: The primary endpoint is progression-free survival (PFS). PFS is defined as the time interval between the date of randomization and the date of progression (according to RECIST v1.1) or death, whichever occurs first.
Endpoint(s): OS is defined as the time interval between the date of randomization and the date of death of any cause., Best response under treatment: Best response (as per RECIST v1.1) recorded from randomization's date until the end of treatment.Each patient will be assigned one of the following categories: complete response,partial response,stable disease,disease progression, or unevaluable for response (specify reasons,e.g. early death,malignant disease;toxicity;tumor assessment not repeated/incomplete;other).Responses will have to be confirmed at least 4 weeks after evaluation to exclude measurement errors, Time until definitive deterioration (TUDD) of Health-related quality of life (HRQoL) is defined as the time interval between the date of randomization and the date of first deterioration of at least 10 points of the HRQoL score compared to baseline score, without any subsequent improvement as detailed further in Bonnetain et al. HRQoL will be assessed through Quality of life questionnaire - Core 30 (QLQ-C30) and Quality of life questionnaire – Elderly cancer patients (QLQ-ELD14)., Toxicity: Adverse events will be graded according to the CTCAE v5.0., Identification of prognostic factors of PFS and OS., Geriatric condition. Based on the recent work of the DIALOG task force for definition of G-CODE for clinical oncology research, geriatric data will be collected as follows : • 1. Social environment: 2 questions - • 2. Functional status: ADL and 4-IADL 3. Mobility: Time Get Up and Go test (TUG) • 4. Nutritional Status: Weight loss during the last 6 months and BMI. 5. Cognitive status: Mini-Cog • 6. Depressive mood: Mini-GDS • 7. Comorbidities:, Compliance to oral metronomic cyclophosphamide (arm B only): compliance will be assessed based on data reported by the patients (patient diary).

Source: https://euclinicaltrials.eu/ctis-public/view/2024-510653-10-00